EU clinical trial 2023-508560-29-00: A randomised controlled trial of a moisturiser for treatment of dry skin in atopic dermatitis: effect on the skin barrier in adults with a history of eczema
Protocol code: CSCI-SKT-B1001
Sponsor: ACO Hud Nordic AB (Pharmaceutical company). Phase: Therapeutic exploratory (Phase II). Countries: Germany (ended).
Therapeutic area(s): Diseases [C] - Skin and Connective Tissue Diseases [C17]
Gender: Female, Male. Age: 18-64 years, 65+ years. Enrolment: 55.
Status: Ended. Start date (EU): 2023-12-07. End date (EU): 2024-03-14. Decision date: 2023-12-07. Results received: Yes. Last updated: 2024-04-15.

Condition(s): Atopic dermatitis
Product: SODIUM LAURILSULFATE, Canoderm 5 % kräm, Aqua ad iniectabilia Braun Lösungsmittel zur Herstellung von Parenteralia, Propyless 200 mg/g kutan emulsion, Miniderm 20 % kräm, CARBAMIDE, COMBINATIONS

Primary endpoint: Comparison of IPs on Trans Epidermal Water Loss (TEWL) on visit 3 and visit 5 between: • test product vs no treatment • test product vs Propyless®
Endpoint(s): Comparison of test product vs 1) no treatment; 2) Propyless®; 3) Canoderm® for each of the following parameters:, Comparison of TEWL on Visit 3 and Visit 5 between test product vs Canoderm®., 2. Comparison of TEWL on Visit 3 between test product and comparators as well as no treatment., Comparison of difference to baseline (Visit 2) of TEWL on Visit 3 between test product and comparators as well as no treatment., Comparison of TEWL on Visit 5 between test product and comparators as well as no treatment., Comparison of difference to Visit 3 for scoring of SLS irritant reactions on Visit 5 between test product and comparators as well as no treatment., Comparison of scoring of SLS irritant reactions on Visit 5 between test product and comparators as well as no treatment., Comparison of redness assessment based on images [Picture analysis, USR-Clip] (redness on Visit 5 minus redness on Visit 3) between test product and comparators as well as no treatment., Comparison of capacitance measurements on Visit 3 between test product and comparators as well as no treatment., Comparison of difference to baseline (Visit 2) of capacitance measurements on Visit 3 between test product and comparators as well as no treatment., Comparison of skin pH on Visit 3 between test product and comparators as well as no treatment., Comparison of difference to baseline (Visit 2) of skin pH on Visit 3 between test product and comparators as well as no treatment., Comparison of product consumption (in gram) over 28 days of treatment between test product and comparators.

Source: https://euclinicaltrials.eu/ctis-public/view/2023-508560-29-00